EU clinical trial 2023-510091-31-00: A randomized clinical two-arm trial comparing inflammation and cystoid macular edema for the medication regimens postoperative topical NSAIDs and steroids to only postoperative topical steroids in patients undergoing corneal endothelial transplantations (DMEC).
Sponsor: Oslo University Hospital HF (Hospital/Clinic/Other health care facility). Phase: Therapeutic use (Phase IV). Countries: Norway (ongoing, recruiting).
Therapeutic area(s): Diseases [C] - Eye Diseases [C11]
Gender: Female, Male. Age: 18-64 years, 65+ years. Enrolment: 120.
Status: Ongoing, recruiting. Start date (EU): 2022-12-02. Decision date: 2024-10-15. Results received: No. Last updated: 2024-10-15.

Condition(s): Fuchs dystrophy
Product: NEVANAC 3 mg/ml eye drops, suspension, Spersadex 1 mg/ml øyedråper, oppløsning

Primary endpoint: • Central macular thickness and macular cysts on optical coherence tomography
Endpoint(s): • Laser flare, • Peroperative factors, e.g. operation time (minutes), iris lesion (none, some, much), pigment loss (none, some, much), intraocular manipulation (none, some, much), • IOP in mmHg (applanation and iCare), • Corrected distance visual acuity (in logMAR), • Corneal endothelial cell density (measured with confocal microscopy, in cells/mm2)

Source: https://euclinicaltrials.eu/ctis-public/view/2023-510091-31-00